EU clinical trial 2022-502552-31-00: A 2-Part, Multicenter, Randomized, Blinded, Active-Controlled Phase 2 Study to Sequentially Evaluate the Safety and Efficacy of BIIB091 Monotherapy and BIIB091 Combination Therapy With Diroximel Fumarate in Participants With Relapsing Forms of Multiple Sclerosis
Protocol code: 257MS201
Sponsor: Biogen Idec Research Limited (Pharmaceutical company). Phase: Therapeutic exploratory (Phase II). Countries: Germany (ended), Czechia (ended), Spain (ended), Italy (ended), Poland (ended), Bulgaria (ended), Romania (ended).
Therapeutic area(s): Diseases [C] - Nervous System Diseases [C10]
Gender: Female, Male. Age: 18-64 years. Enrolment: 225.
Status: Ended. Start date (EU): 2023-10-03. End date (EU): 2026-02-02. End date: 2026-02-10. Decision date: 2023-08-14. Results received: No. Last updated: 2026-02-24.
Decision dates by country: DE: 2023-08-15, IT: 2023-08-16, BG: 2023-10-20, ES: 2023-08-14, CZ: 2023-08-16, PL: 2023-11-15, RO: 2023-11-27

Condition(s): Relapsing Forms of Multiple Sclerosis
Product: BIIB091, Solu-Moderín 125 mg polvo y disolvente para solución inyectable, Use of placebo is for masking purposes only in this study. all participants will be randomized to one of the active treatment arms. this study does not have a placebo control group, i.e., no participant will receive placebo treatment only., Clariscan 0,5 mmol/ml Injektionslösung, BIIB091, Use of placebo is for masking purposes only in this study. All participants will be randomized to one of the active treatment arms. This study does not have a placebo control group, i.e., no participant will receive placebo treatment only., Vumerity 231 mg gastro-resistant hard capsules

Primary endpoint: Part 1: Number of Participants With Adverse Events (AEs), Part 1: Number of Participants With Serious Adverse Events (SAEs), Part 2: Cumulative Number of New T1 Gadolinium-Enhancing (GdE) Lesions
Endpoint(s): Part 1: Cumulative Number of New T1 Gadolinium-Enhancing (GdE) Lesions, Part 1: Cumulative Number of New or Enlarging T2 Hyperintense Lesions, Part 1: Cumulative Volume of New or Enlarging T2 Hyperintense Lesions, Part 1: Mean Change From Baseline in QT Interval Corrected for Heart Rate Using Fridericia's Formula (QTcF), RR, PR, QRS, and QT Intervals, Part 1: Number of Participants With Change From Baseline in Heart Rate, Part 1: Number of Participants With Clinically Significant Electrocardiogram (ECG) Abnormalities, Part 2: Cumulative Number of New or Enlarging T2 Hyperintense Lesions, Part 2: Cumulative Volume of New or Enlarging T2 Hyperintense Lesions, Part 2: Number of Participants With AEs, Part 2: Number of Participants With SAEs, Part 2: Number of Participants With Change From Baseline in QTcF, RR, PR, QRS, and QT intervals, Part 2: Number of Participants With Change From Baseline in Heart Rate, Part 2: Number of Participants With ECG Abnormalities as Assessed by 12-Lead ECG Measurements

Source: https://euclinicaltrials.eu/ctis-public/view/2022-502552-31-00